EU clinical trial 2024-514446-36-00: A Study of ZL-1310 in Patients with Small Cell Lung Cancer to Find a Suitable Dose and to Test How Different Doses of ZL-1310 are Tolerated by the Body and How the Body Absorbs, Distributes, Metabolizes and Excretes ZL-1310
Protocol code: ZL-1310-001
Sponsor: Zai Lab (US) LLC (Pharmaceutical company). Phase: Human Pharmacology (Phase I)- First administration to humans. Countries: Spain (ongoing, recruiting).
Therapeutic area(s): Diseases [C] - Neoplasms [C04]
Gender: Female, Male. Age: 18-64 years, 65+ years. Enrolment: 80.
Status: Ongoing, recruiting. Start date (EU): 2024-11-21. Decision date: 2024-10-31. Results received: No. Last updated: 2026-04-27.

Condition(s): Small Cell Lung Cancer

Source: https://euclinicaltrials.eu/ctis-public/view/2024-514446-36-00